EU clinical trial 2023-503281-23-00: A seamless Phase I/II trial with an initial open-label dose escalation part and a subsequent randomised, double-blind, placebo-controlled expansion part to evaluate the safety, tolerability, and efficacy of a single dose of BI 3720931, an inhaled lentiviral vector gene therapy, in adult people with cystic fibrosis who are ineligible for CFTR modulators (LenticlairTM 1)
Protocol code: 1504-0001
Sponsor: Boehringer Ingelheim International GmbH, Boehringer Ingelheim Espana S.A. (Industry, Pharmaceutical company). Phase: Phase I and Phase II (Integrated)- First administration to humans. Countries: Italy (ended), Spain (ended), Netherlands (ended), France (ended).
Therapeutic area(s): Diseases [C] - Respiratory Tract Diseases [C08]
Gender: Female, Male. Age: 18-64 years, 65+ years. Enrolment: 12.
Status: Ended. Start date (EU): 2024-12-19. End date (EU): 2026-02-03. Decision date: 2024-06-17. Results received: No. Last updated: 2025-07-22.
Decision dates by country: IT: 2024-06-18, NL: 2024-06-19, ES: 2024-06-17, FR: 2024-06-24

Condition(s): Cystic fibrosis
Product: BI 3720931, Gadovist 1.0 mmol/ml solution for injection, Solvent for dilution for BI 3720931 inhaler solution, BI 3720931

Primary endpoint: Phase I: Occurrence of any drug-related, treatment-emergent AE up to Week 24 after drug administration, Phase II: Absolute change from baseline in FEV1pp at Week 8 after drug administration
Endpoint(s): Phase I: Occurrence of treatment response defined as change from baseline ≥5% in FEV1pp, comparing the mean of 3 pre-treatment FEV1pp measured in the screening period with the mean of 3 post treatment FEV1pp values at Weeks 4, 6, and 8, Phase I: Absolute change from baseline in FEV1pp at Week 24 after drug administration, Phase I: Occurrence of any DLTs up to Week 24 after drug administration, Phase II: Absolute change from baseline in FEV1pp at Week 24 after drug administration, Phase II: Occurrence of any SAEs up to Week 24 after drug administration, Phase II: Occurrence of any drug-related, treatment-emergent AEs up to Week 24 after drug administration

Source: https://euclinicaltrials.eu/ctis-public/view/2023-503281-23-00